EU clinical trial 2024-516735-27-00: Open Label Extension Study to Evaluate the Long-Term Safety and Efficacy of Pegunigalsidase Alpha (PRX-102) 2 mg/kg Administered by Intravenous Infusion Every 4 Weeks in Patients with Fabry Disease
Protocol code: CLI-06657AA1-03
Sponsor: Chiesi Farmaceutici S.p.A. (Pharmaceutical company). Phase: Therapeutic confirmatory (Phase III). Countries: Czechia (ended), Italy (ended), Norway (ended), Belgium (ended), Denmark (ended).
Therapeutic area(s): Diseases [C] - Congenital, Hereditary, and Neonatal Diseases and Abnormalities [C16]
Gender: Female, Male. Age: 18-64 years. Enrolment: 10.
Status: Ended. Start date (EU): 2019-01-31. End date (EU): 2026-03-10. End date: 2026-04-13. Decision date: 2024-09-13. Results received: No. Last updated: 2026-03-10.
Decision dates by country: BE: 2024-09-13, DK: 2024-09-13, IT: 2024-09-23, CZ: 2024-09-16, NO: 2024-09-18

Condition(s): Fabry disease (α-galactosidase A deficiency)

Primary endpoint: Safety. Changes from baseline in: • Clinical laboratory tests. • Physical examination. • Assessment of the injection site. • Electrocardiography • Brain MRI. • Treatment-emergent adverse events • The ability to taper off infusion’s pre-medication at the start of the study. • Requirement for the use of premedication overall to manage infusion reactions. • Treatment-induced anti-pegunigalsidase alfa antibodies., Efficacy. • Estimated glomerular filtration rate (eGFRCKD-EPI). • Left Ventricular Mass Index (g/m2) by echocardiogram. • Plasma Lyso-Gb3 concentration. • Plasma Gb3 concentration • Protein/Creatinine ratio, spot urine test • Frequency of pain medication use. • Exercise tolerance (Stress Test). • Short Form Brief Pain Inventory (BPI). • Mainz Severity Score Index (MSSI). • Quality of life (EQ-5D-5L).

Source: https://euclinicaltrials.eu/ctis-public/view/2024-516735-27-00